EU clinical trial 2024-515062-13-00: Treatment of acute ischemic stroke due to occlusion of a large vessel by mechanical thrombectomy in patients with unknown onset or not meeting the criteria for CT eligibility (ASPECTS <6) based on MRI criteria (DWIFLAIR mismatch)
Protocol code: NBK241/2/2022
Sponsor: Medical University Of Gdansk (Educational Institution). Phase: Therapeutic confirmatory (Phase III). Countries: Poland (ongoing, recruiting).
Therapeutic area(s): Diseases [C] - Nervous System Diseases [C10]
Gender: Female, Male. Age: 18-64 years, 65+ years. Enrolment: 264.
Status: Ongoing, recruiting. Start date (EU): 2025-01-14. Decision date: 2024-12-09. Results received: No. Last updated: 2024-12-09.

Condition(s): acute ischemic stroke caused by occlusion of a large vessel
Product: ACETYLSALICYLIC ACID

Primary endpoint: Primary clinical efficacy endpoints: • mRS favorable (mRS less than or equal to 2) at 90 days. • Change in hyperintense area volume in the DWI and FLAIR sequences between baseline, 7 days and 90 days (where possible). Primary safety endpoints: • Symptomatic intracerebral haemorrhage (sICH) assessed with ECASS 2 criteria within 24 hours (any intracranial haemorrhage with neurological deterioration of at least 4 points on the NIHSS or any fatal haemorrhage)
Endpoint(s): • Reduction in NIHSS ≥ 4 and ≥ 8 points separately at 24 hrs, 48 hrs, and 7 days • The patient's quality of life within selected domains with Beck Depression Rating Scale, the EQ-5D-5L Scale and the Barthel Scale. • The technical outcome of the procedure (grading the degree of recanalization) assessed with the Thrombolysis in Cerebral Ischemia (TICI) scale.

Source: https://euclinicaltrials.eu/ctis-public/view/2024-515062-13-00